EU clinical trial 2025-524738-24-00: Healing Diabetic Foot Ulcers with Semaglutide
Protocol code: R0126321A
Sponsor: Radboud universitair medisch centrum Stichting (Hospital/Clinic/Other health care facility). Phase: Therapeutic use (Phase IV). Countries: Netherlands (ongoing, recruiting).
Therapeutic area(s): Diseases [C] - Cardiovascular Diseases [C14]
Gender: Female, Male. Age: 18-64 years, 65+ years. Enrolment: 70.
Status: Ongoing, recruiting. Start date (EU): 2026-07-29. Decision date: 2026-03-30. Results received: No. Last updated: 2026-05-19.
Decision dates by country: NL: 2026-05-19

Condition(s): Diabetic foot ulcer
Product: Ozempic 1 mg solution for injection in pre-filled pen, Ozempic 0.5 mg solution for injection in pre-filled pen, Ozempic 2 mg solution for injection in pre-filled pen, Ozempic 0.25 mg solution for injection in pre-filled pen

Primary endpoint: Time (in weeks) to wound closure in patients with a DFU using semaglutide versus standard of care treatment.
Endpoint(s): Rate of >50% reduction in ulcer surface area after 6 week of treatment between study groups (excluding newly formed ulcers), Ulcer surface area and depth at every outpatient clinic (relative to baseline), The change in ankle-brachial index/toe pressure measurements over time (at inclusion, and after wound closure of 6 months of follow-up), Rate of lower limb amputation, Rate of endovascular intervention in lower extremities, Rate of infection

Source: https://euclinicaltrials.eu/ctis-public/view/2025-524738-24-00